EU clinical trial 2024-516197-30-00: A phase 1 multi-centre, randomized, single-blind, steady-state study to evaluate pharmacokinetics, pharmacodynamics, safety and tolerability after multiple-dose administration of three different doses of naronapride in patients with moderate idiopathic or diabetic gastroparesis compared to healthy subjects
Protocol code: NAT-022/BIO
Sponsor: Dr. Falk Pharma GmbH (Pharmaceutical company). Phase: Human Pharmacology (Phase I)- Other. Countries: Germany (ongoing, recruiting), Belgium (ongoing, recruiting), Poland (ongoing, recruiting).
Therapeutic area(s): Diseases [C] - Digestive System Diseases [C06]
Gender: Female, Male. Age: 18-64 years, 65+ years. Enrolment: 60.
Status: Ongoing, recruiting. Start date (EU): 2025-07-16. Decision date: 2025-04-25. Results received: No. Last updated: 2026-03-24.
Decision dates by country: DE: 2025-04-25, PL: 2025-09-27, BE: 2025-08-26

Condition(s): Idiopathic or diabetic gastroparesis

Source: https://euclinicaltrials.eu/ctis-public/view/2024-516197-30-00